EU clinical trial 2022-500045-25-00: Calcium electroporation in combination with irreversible electroporation and immunotherapy in patients with pMMR metastatic colorectal cancer - A prospective, phase 2 study
Protocol code: 010222
Sponsor: Zealand University Hospital (Hospital/Clinic/Other health care facility). Phase: Therapeutic exploratory (Phase II). Countries: Denmark (ended).
Therapeutic area(s): Diseases [C] - Neoplasms [C04]
Gender: Female, Male. Age: 18-64 years, 65+ years. Enrolment: 12.
Status: Ended. Start date (EU): 2023-01-26. End date (EU): 2024-05-17. Decision date: 2022-04-07. Results received: Yes. Last updated: 2022-04-07.

Condition(s): Colorectal cancer
Product: KEYTRUDA 25 mg/mL concentrate for solution for infusion, CALCIUM CHLORIDE HEXAHYDRATE

Primary endpoint: To evaluate the safety and tolerability of Ca-EP and IRE in combination with pembrolizumab
Endpoint(s): To evaluate the systemic response, measured by biopsy data from a metastasis not treated with IRE, To evaluate the efficacy of Ca-EP and IRE in combination with pembrolizumab, To evaluate tumor response per Response Evaluation Criteria in Solid Tumors (RECIST), version 1.1, To evaluate tumor response by dynamic contrast enhanced ultra sound (DCE-US), To evaluate the phenotypic change of the TILs from the primary tumor by flow cytometry, To evaluate progression free survival, To evaluate overall survival, To evaluate quality of life (by questionnaire EORTC QLQ-C30)

Source: https://euclinicaltrials.eu/ctis-public/view/2022-500045-25-00